EU clinical trial 2024-518685-27-00: EMpagliflozin and daPAgliflozin in patients hospiTalized for acute decompensated Heart failure (EMPATHY) – a phase III Trial
Protocol code: EMPATHY
Sponsor: Medical University Of Warsaw (Educational Institution). Phase: Therapeutic confirmatory (Phase III). Countries: Poland (ongoing, recruitment ended).
Therapeutic area(s): Diseases [C] - Cardiovascular Diseases [C14]
Gender: Female, Male. Age: 18-64 years. Enrolment: 1364.
Status: Ongoing, recruitment ended. Start date (EU): 2022-03-22. Decision date: 2024-12-02. Results received: No. Last updated: 2024-12-02.

Condition(s): acute/decompensated heart failure
Product: Placebo_dapagliflozin_10mg, DAPAGLIFLOZIN, EMPAGLIFLOZIN, Placebo_Empagliflozin_10mg

Primary endpoint: Composite primary endpoint - time to first event of all-cause death or worsening HF (defined as worsening signs or symptoms of HF that require an intensification of diuretic therapy or any other intravenous therapy for HF or mechanical ventilatory, renal or circulatory support) or HF readmission (unplanned ambulatory visit or hospitalization due to symptoms of HF through 3 months).
Endpoint(s): Composite endpoint - time to first event of all-cause death or worsening HF (defined as worsening signs or symptoms of HF that require an intensification of diuretic therapy or any other intravenous therapy for HF or mechanical ventilatory, renal or circulatory support) or HF readmission (unplanned ambulatory visit or hospitalization due to symptoms of HF through 9 months, Difference in the number of recurrent hospitalizations due to heart failure between the treatment groups: at 3 and 9 months, Difference in the number of hospitalizations for CV causes between the treatment groups: - time frame: at 3 and 9 months., Difference in the number of hospitalizations for other than CV causes between the treatment groups: - time frame: at 3 and 9 months., Time to adjudicate CV death- time frame: at 3 and 9 months., Time to adjudicate all causes of death- time frame: at 3 and 9 months., Time to adjudicate myocardial infarction- time frame: at 3 and 9 months, eGFR (Estimated Glomerular Filtration Rate) (CKD-EPI (Chronic Kidney Disease Epidemiology Collaboration Equation)) CR slope of change from baseline: at 3 and 9 months, Difference in the number of hospital readmissions due to heart failure between the treatment groups- time frame: at 3 and 9 months, Difference in the number of hospital readmissions for any cause between the treatment groups- time frame: at 3 and 9 months, Difference in the duration of hospital stay between the treatment groups after initiation of the study treatment- time frame: at 3 and 9 months., Difference in the number of incidences of new onset AF and re-occurrence of AF between treatment groups- time frame: at 3 and 9 months., Difference in the change of ejection fraction in echocardiography between treatment groups from randomization to 3 and 9 months, Difference in the change of left ventricular diastolic function in echocardiography from randomization to 3 and 9 months., Difference in the change of LV strain analysis in echocardiography from randomization to 3 and 9 months., The time-averaged proportional change in NT-proBNP from baseline through 3 and 9 months., Personalized medicine based on biomarker approach- the time-averaged proportional change in selected ncRNA expression linked to hypertrophy, inflammation, fibrosis, apoptosis, electric stability between treatment groups and placebo group from baseline through months 3 and 9., Personalized medicine based on biomarker approach- the time-averaged proportional change in PCT- procalcitonin, ANP - atrial natriuretic peptide, FGF-23 - fibroblast growth factor-23, GDF-15 - growth differentiation factor-15, IL-2 - interleukin 2, IL-6 - interleukin 6 between treatment groups and placebo group from baseline through months 3 and 9., Personalized medicine based on biomarker approach- association between primary and secondary clinical endpoints and microbiome metabolites at baseline in both treatment groups and placebo in long term follow-up (3 and 9 months)., Personalized medicine based on biomarker approach- association between primary and secondary clinical endpoints and metabolome at baseline in both treatment groups and placebo in long term follow-up (3 and 9 months)., Cost-effectiveness substudy., Effect of SGLT-2 inhibitors according to clinical characteristics as age, gender., Symptoms, Function, and Quality of Life substudy, Polypharmacy substudy, Effect of SGLT-2 inhibitors on cardiac muscle fibrosis based on magnetic resonance (MR) substudy.

Source: https://euclinicaltrials.eu/ctis-public/view/2024-518685-27-00